EU clinical trial 2023-504151-27-00: Open-Label Extension Study to Assess the Long-Term Safety and Tolerability of KarXT in Subjects with Psychosis Associated with Alzheimer’s Disease (ADEPT-3)
Protocol code: KAR-033
Sponsor: Karuna Therapeutics Inc. (Pharmaceutical company). Phase: Therapeutic confirmatory (Phase III). Countries: Italy (ongoing, recruiting), France (ongoing, recruiting), Czechia (ongoing, recruiting), Bulgaria (ongoing, recruiting), Germany (ended), Slovakia (ongoing, recruiting), Croatia (ongoing, recruiting), Spain (ongoing, recruiting), Belgium (ended), Greece (authorised, recruitment pending), Hungary (authorised, recruitment pending), Poland (ongoing, recruiting), Portugal (ongoing, recruiting), Romania (ongoing, recruiting).
Therapeutic area(s): Diseases [C] - Nervous System Diseases [C10]
Gender: Female, Male. Age: 18-64 years, 65+ years. Enrolment: 264.
Start date (EU): 2024-05-09. Decision date: 2024-02-05. Results received: No. Last updated: 2026-07-03.
Decision dates by country: CZ: 2024-02-07, PT: 2025-06-23, SK: 2024-04-11, BE: 2024-07-08, BG: 2024-02-07, RO: 2025-08-11, FR: 2024-02-07, HR: 2024-04-08, IT: 2024-02-06, PL: 2024-07-30, ES: 2024-02-07, DE: 2024-02-05, GR: 2024-07-30, HU: 2024-07-16

Condition(s): Psychosis associated with Alzheimer’s Disease
Product: KarXT, KarXT, KarXT, KarXT, KarXT

Primary endpoint: Incidence of TEAEs
Endpoint(s): Incidence of serious TEAEs Incidence of TEAEs leading to discontinuation of IMP

Source: https://euclinicaltrials.eu/ctis-public/view/2023-504151-27-00